EU clinical trial 2023-509759-15-00: A prospective, randomized, phase III open-label clinical trial with blinded ebd-point assessment to evaluate the efficacy and safety of cyclosporine and methoterxate in chlidren and adolescent subjects with moderate-to-severe atopic dermatitis.
Protocol code: 020520
Sponsor: Medical University Of Lodz (Educational Institution). Phase: Therapeutic confirmatory (Phase III). Countries: Poland (ongoing, recruitment ended).
Therapeutic area(s): Diseases [C] - Skin and Connective Tissue Diseases [C17]
Gender: Female, Male. Age: 0-17 years. Enrolment: 317.
Status: Ongoing, recruitment ended. Start date (EU): 2021-03-15. Decision date: 2024-12-02. Results received: No. Last updated: 2026-06-03.

Condition(s): atopic dermatitis
Product: METHOTREXATE, MOMETASONE FUROATE, METHOTREXATE, METHOTREXATE, CICLOSPORIN, METHOTREXATE, TACROLIMUS, TACROLIMUS

Primary endpoint: Proportion of patients achieving 75% improvement in EASI (EASI75) from baseline at week 32.
Endpoint(s): Proportion of patients achieving 75% improvement in EASI (EASI75) from baseline at week 16., Percent change in EASI score from baseline to week 16., Percent change in EASI score from baseline to week 32., Proportion of patients with Investigator’s Global Assessment (IGA) 0 (clear) or 1 (almost clear) at week 16., Proportion of patients with Investigator’s Global Assessment (IGA) 0 (clear) or 1 (almost clear) at week 32., Change in Scoring Atopic Dermatitis (SCORAD) from baseline to week 16, Change in Scoring Atopic Dermatitis (SCORAD) from baseline to week 32., Itch Reduction of Pruritus in numeric rating scale (NRS) and in VAS (visual analogue scale) from baseline to Week 16., Itch Reduction of Pruritus in numeric rating scale (NRS) and in VAS (visual analogue scale) from baseline to Week 32., Change in Children’s Dermatology Life Quality Index (CDLQI) score from baseline to Week 16., Change in Children’s Dermatology Life Quality Index (CDLQI) score from baseline to Week 32, Change in Family Dermatology Life Quality Index (FDQL) from baseline to week 16., Change in Family Dermatology Life Quality Index (FDQL) from baseline to week 32., Change in Infant’s Dermatitis Quality of Life (IDQI) from baseline to week 16., Change in Infant’s Dermatitis Quality of Life (IDQI) from baseline to week 32., Change in Patient-Oriented Eczema Measure (POEM) from baseline to week 16., Change in Patient-Oriented Eczema Measure (POEM) from baseline to week 32., Incidence of treatment-emergent AE from baseline through week 16., Incidence of treatment-emergent AE from baseline through week 32., Incidence of treatment-emergent AE leading to treatment discontinuation from baseline through week 16., Incidence of treatment-emergent AE leading to treatment discontinuation from baseline through week 32., Time to exacerbation of AD (loss of at least 50% of the EASI response at week 32) after treatment cessation at week 32.

Source: https://euclinicaltrials.eu/ctis-public/view/2023-509759-15-00